EU clinical trial 2024-516253-49-01: HER2 molecular imaging with 89Zr-trastuzumab PET/CT as a predictive biomarker for antibody-drug conjugate sequencing in patients with advanced HER2-positive breast cancer
Protocol code: IJB-ZEPHIR02-2024
Sponsor: Institut Jules Bordet (Hospital/Clinic/Other health care facility). Phase: Therapeutic exploratory (Phase II). Countries: Belgium (authorised, recruiting), Netherlands (authorised, recruitment pending).
Therapeutic area(s): Diseases [C] - Neoplasms [C04]
Gender: Female, Male. Age: 18-64 years, 65+ years. Enrolment: 109.
Start date (EU): 2025-12-12. Decision date: 2025-09-29. Results received: No. Last updated: 2026-05-18.
Decision dates by country: BE: 2025-09-29, NL: 2026-05-18

Condition(s): advanced/metastatic HER2-positive breast carcinoma
Product: 89Zr-Trastuzumab_IJB, Herceptin 150 mg powder for concentrate for solution for infusion, TRASTUZUMAB EMTANSINE

Primary endpoint: Characterization of genomic alterations and HER2 expression., Time to treatment failure (TTF): defined as the time from T-DM1 start to discontinuation for any reason, including disease progression (clinical or image-based on 18FDG-PET/CT), treatment toxicity or death in participants with a “positive” HER2-PET/CT (per metabolic response)
Endpoint(s): Overall response to T-DM1 assessed by metabolic response (subjects with a “positive” HER2-PET/CT)., OS defined from the start of treatment to the date of death from any cause (subjects with a “positive” HER2-PET/CT)., DoR defined as the time from the date of first documentation of response (CR or PR) to disease progression or death, in participants who achieve complete or partial response assessed by metabolic response (subjects with a “positive” HER2-PET/CT).., DCR defined as absence of disease progression (subjects with a “positive” HER2-PET/CT)., Incidence, nature, and severity of adverse events, including but not limited to drug induced liver injury, described in the section 9.1.2.2 “Recording and reporting of AEs by the investigators” and in the section 9.2.1 “Adverse Events of Special Interest – Definitions”

Source: https://euclinicaltrials.eu/ctis-public/view/2024-516253-49-01